EU clinical trial 2024-511220-14-00: A study to compare the relative potency of salbutamol administered via metered dose inhalers containing propellants HFA-152a to HFA-134a in mild asthmatics aged 18 to 65 inclusive.
Protocol code: 219729
Sponsor: Glaxosmithkline Research & Development Limited (Pharmaceutical company). Phase: Human Pharmacology (Phase I)- Other. Countries: Germany (authorised, recruitment pending), Romania (ended), Bulgaria (authorised, recruitment pending), Poland (authorised, recruitment pending).
Therapeutic area(s): Diseases [C] - Respiratory Tract Diseases [C08]
Gender: Female, Male. Age: 18-64 years, 65+ years. Enrolment: 53.
Decision date: 2024-09-18. Results received: No. Last updated: 2026-07-20.
Decision dates by country: BG: 2024-09-27, RO: 2024-09-30, DE: 2024-09-18, PL: 2024-09-30

Condition(s): Mild Asthma

Source: https://euclinicaltrials.eu/ctis-public/view/2024-511220-14-00